EU clinical trial 2023-508718-40-00: Quantification tools for a novel tau PET marker in a rare neurological disease: 18F-PI-2620 in progressive supranuclear palsy
Sponsor: Fundacio De Recerca Clinic Barcelona-Institut D’investigacions Biomediques August Pi I Sunyer (Laboratory/Research/Testing facility). Phase: Therapeutic exploratory (Phase II). Countries: Spain (ongoing, recruiting).
Therapeutic area(s): Diseases [C] - Nervous System Diseases [C10]
Gender: Female, Male. Age: 18-64 years, 65+ years. Enrolment: 66.
Status: Ongoing, recruiting. Start date (EU): 2025-01-09. Decision date: 2024-03-05. Results received: No. Last updated: 2024-03-05.

Condition(s): Progressive supranuclear palsy, Parkinson's disease
Product: [18F]PI-2620

Primary endpoint: PI-2620 uptake determined by standard uptake value ratio (SUVR)
Endpoint(s): SUVR of the base nuclei divided a reference region such as the brain stem., SUVR of the cerebral cortex divided into a reference region such as the brain stem., Association of PI-2620 uptake values with demographics, clinical variables and CSF biomarkers

Source: https://euclinicaltrials.eu/ctis-public/view/2023-508718-40-00